EU clinical trial 2024-519631-42-00: LEVOMEMS: Comparison of the Hemodynamic Profile of Dobutamine and Levosimendan in the Current Therapeutic Context
Protocol code: LEVOMEMS
Sponsor: Instituto De Investigacion En Ciencias De La Salud Germans Trias I Pujol (Laboratory/Research/Testing facility). Phase: Phase III and phase IV (Integrated). Countries: Spain (authorised, recruitment pending).
Therapeutic area(s): Diseases [C] - Cardiovascular Diseases [C14]
Gender: Female, Male. Age: 18-64 years, 65+ years. Enrolment: 10.
Status: Authorised, recruitment pending. Decision date: 2024-12-03. Results received: No. Last updated: 2024-12-03.

Condition(s): Heart failure patients with depressed left ventricular ejection fraction
Product: DOBUTAMINE, LEVOSIMENDAN

Primary endpoint: Pulmonary blood pressure measured in mmhg and cardiac output measured in l / min at 3 months
Endpoint(s): Combined criteria for death or rehospitalization for heart failure at the beginning and end of each period, Scores observed in the EuroQoL-5D quality of life test at the beginning and end of each period., Scores observed in the 6-minute test at the beginning and end of each period, CA125, ST2, TnT and NTProBNP levels at the beginning and end of each period., Pulmonary congestion parameters by pulmonary ultrasound: B lines, Renal function parameters:% of glomerular filtrate or creatinine levels (mg / dl), hypotension (systolic blood pressure <100mmHg)., Adverse events resulting from the administration of the drug

Source: https://euclinicaltrials.eu/ctis-public/view/2024-519631-42-00